EU clinical trial 2024-511297-73-00: MK-2420 SAD Study
Protocol code: MK-2420-001
Sponsor: Merck Sharp & Dohme LLC (Pharmaceutical company). Phase: Human Pharmacology (Phase I)- First administration to humans. Countries: Belgium (ended).
Therapeutic area(s): Diseases [C] - Immune System Diseases [C20]
Gender: Male. Age: 18-64 years. Enrolment: 96.
Status: Ended. Start date (EU): 2024-05-03. End date (EU): 2025-02-24. End date: 2025-02-25. Decision date: 2024-04-25. Results received: No. Last updated: 2024-10-11.

Condition(s): Rheumatoid arthritis

Source: https://euclinicaltrials.eu/ctis-public/view/2024-511297-73-00